EU clinical trial 2024-516429-30-00: VIRTUOSE: Efficiency of sildenafil on the absolute claudication distance of peripheral arterial disease patients with intermittent claudication. A phase III, National, Multicenter, Prospective, Randomized, Double-blind, Placebo-Controlled trial.
Protocol code: 35RC17_8844_VIRTUOSE
Sponsor: Centre Hospitalier Universitaire De Rennes (Hospital/Clinic/Other health care facility). Phase: Therapeutic confirmatory (Phase III). Countries: France (ended).
Therapeutic area(s): Diseases [C] - Cardiovascular Diseases [C14]; Phenomena and Processes [G] - Circulatory and Respiratory Physiological Phenomena [G09]; Diseases [C] - Pathological Conditions, Signs and Symptoms [C23]
Gender: Female, Male. Age: 18-64 years, 65+ years. Enrolment: 220.
Status: Ended. Start date (EU): 2021-11-24. End date (EU): 2025-10-06. Decision date: 2024-10-01. Results received: No. Last updated: 2025-09-08.

Condition(s): Peripheral arterial disease
Product: MICROCRYSTALLINE CELLULOSE, SILDENAFIL CITRATE

Primary endpoint: Absolute change of the absolute claudication distance (ACD) from baseline to week 24. ACD is measured in meters at baseline and week 24 by walking on a treadmill until the point when the subject is unable to walk anymore due to pain in the leg. For the treadmill tests, walking will be conducted up to the maximum walking ability (not only the appearance of a pain) or to a maximum of 15 minutes.
Endpoint(s): Rate of patients with surgical revascularization at weeks 24 and 48, Absolute change of the ACD from baseline to week 48: For the treadmill tests, walking will be conducted up to the maximum walking ability (not only the appearance of a pain) or to a maximum of 15 minutes., Event free survival (EFS) from baseline until week 48: An "EVENT" is defined as either (1) major adverse cardiovascular events (MACE; including vascular deaths, non-fatal myocardial infarction and non-fatal stroke), (2) leg amputations, (3) Non Cardiovascular death. Event-free survival is defined as the time from inclusion to the first documented event. If no event is observed, event-free survival is defined as the delay of follow-up, SF36 questionnaire and Peripheral Artery Questionnaire at baseline, weeks 12, 24 and 48, Change in exercise oximetry results between baseline and weeks 12, 24 and 48, Change in endothelial function between baseline and weeks 12, 24 and 48, Changes in pulmonary function and diffusion capacity of the lungs for carbon monoxide (DLCO) at week 24 from baseline, Changes in arterial stiffness (Pulse Wave Velocity) and Central Blood Pressure with pOpmetre® between baseline and weeks 12, 24 and 4, Changes in arterial compliance and vascular resistance with Finometer® between baseline and weeks 12, 24 and 48, Change in metabolomics signature between baseline and week 24, Compliance with the treatment, Tolerance and perceived symptoms

Source: https://euclinicaltrials.eu/ctis-public/view/2024-516429-30-00